EU clinical trial 2024-519671-26-00: A Multicenter, Randomized, Open-Label, Phase 1b/2 Trial of Valemetostat Tosylate Plus Pembrolizumab vs Pembrolizumab Alone in Participants with Advanced or Metastatic Non-small Cell Lung Cancer whose Tumors Express PD-L1 with Tumor Proportion Score ≥50% Without Actionable Genomic Alterations
Protocol code: DS3201-330
Sponsor: Daiichi Sankyo Inc. (Pharmaceutical company). Phase: Phase I and Phase II (Integrated)- Other. Countries: Spain (ended), France (ended), Italy (ended).
Therapeutic area(s): Diseases [C] - Neoplasms [C04]
Gender: Female, Male. Age: 18-64 years, 65+ years. Enrolment: 21.
Status: Ended. End date (EU): 2026-01-29. Decision date: 2025-09-29. Results received: No. Last updated: 2026-02-04.
Decision dates by country: IT: 2025-09-29, ES: 2025-10-01, FR: 2025-11-21

Condition(s): Advanced or Metastatic Non-Small Cell Lung Cancer
Product: Valemetostat Tosylate, KEYTRUDA 25 mg/mL concentrate for solution for infusion, Valemetostat Tosylate

Primary endpoint: Phase 1b only: Number of Participants with Dose-Limiting Toxicities, Treatment-Emergent Adverse Events, and other safety parameters during the trial., Phase 2 only: Progression-Free survival by blinded independent central review (BICR).
Endpoint(s): Phase 2 only: Objective Response Rate (ORR) by BICR, Phase 2 only: Duration of Response (DoR) by BICR, Phase 2 only: Disease Control Rate (DCR) by BICR, Phase 2 only: Overall Survival (OS), Phase 2 only: Progression-Free Survival by Investigator

Source: https://euclinicaltrials.eu/ctis-public/view/2024-519671-26-00